EU clinical trial 2022-500642-25-00: Evaluation of the decolonization rate and acceptance of a complete nasal decolonization kit with povidone iodine for MRSA patients (MRSAD-PVP-I)
Protocol code: RC21_0556
Sponsor: Centre Hospitalier Universitaire De Nantes (Hospital/Clinic/Other health care facility). Phase: Therapeutic exploratory (Phase II). Countries: France (ended).
Therapeutic area(s): Diseases [C] - Bacterial Infections and Mycoses [C01]
Gender: Female, Male. Age: 18-64 years, 65+ years. Enrolment: 50.
Status: Ended. Start date (EU): 2024-11-21. End date (EU): 2025-12-04. Decision date: 2023-01-17. Results received: No. Last updated: 2023-01-17.

Condition(s): MRSA patients
Product: BETADINE 10 POUR CENT, solution pour bain de bouche, BETADINE 10 POUR CENT, gel, BETADINE SCRUB 4 POUR CENT, solution pour application cutanée (moussante)

Primary endpoint: MRSA nasal decolonization: Negative nasal screening rate 6 hours after use of the kit
Endpoint(s): Acceptability by the patient and HCWs of the use of the complete kit by a satisfactory self-questionnaire, Characteristics of patients remained MRSA positive after PVP-I decolonization, List of adverse events reported by patients, MRSA nasal decolonization: Negative nasal screening rate 24 hours after use of the kit.

Source: https://euclinicaltrials.eu/ctis-public/view/2022-500642-25-00